EU clinical trial 2024-517322-26-00: A Phase 1a/1b Study Investigating the Safety, Tolerability, Pharmacokinetics, Pharmacodynamics, and Antitumor Activity of BG-60366 in Patients With EGFR-Mutant Non-Small Cell Lung Cancer
Protocol code: BG-60366-101
Sponsor: BeOne Medicines AG (Pharmaceutical company). Phase: Human Pharmacology (Phase I)- First administration to humans. Countries: Germany (ended), Italy (ended), Spain (ended).
Therapeutic area(s): Diseases [C] - Neoplasms [C04]
Gender: Female, Male. Age: 18-64 years, 65+ years. Enrolment: 13.
Status: Ended. Start date (EU): 2025-06-06. End date (EU): 2026-04-21. End date: 2026-04-22. Decision date: 2025-05-12. Results received: No. Last updated: 2026-05-04.
Decision dates by country: IT: 2025-05-13, DE: 2025-05-13, ES: 2025-05-12

Condition(s): EGFR-Mutant Non-Small Cell Lung Cancer

Source: https://euclinicaltrials.eu/ctis-public/view/2024-517322-26-00